EU clinical trial 2024-516561-37-01: Control strategies and pharmacogenetic study for the personalized treatment of fatty liver associated with metabolic dysfunction in patients with prediabetes.
Protocol code: PROMETEO-HG
Sponsor: Consorcio Centro De Investigacion Biomedica En Red (Laboratory/Research/Testing facility). Phase: Therapeutic confirmatory (Phase III). Countries: Spain (ongoing, recruiting).
Therapeutic area(s): Diseases [C] - Nutritional and Metabolic Diseases [C18]
Gender: Female, Male. Age: 18-64 years, 65+ years. Enrolment: 390.
Status: Ongoing, recruiting. Start date (EU): 2024-12-19. Decision date: 2024-12-19. Results received: No. Last updated: 2024-12-19.

Condition(s): Metabolic Associated Fatty Liver Disease with prediabetes.
Product: Pioglitazone Holsten 15 mg tabletter, Metformin Hydrochloride 500mg Tablets

Primary endpoint: Significant decrease in the amount of intrahepatic fat (> 20%) in the absence of liver fibrosis progression.
Endpoint(s): Study of insulin resistance and adipose tissue dysfunction, Search for non-invasive markers of efficacy of the proposed treatments among circulating metabolites (metabolomic and lipidomic methods)., Study of the intestinal microbiota., Pharmacogenetic study: influence of genetic variations on the degree of therapeutic response to drugs., Study of bioimpedanciometry., Collection of adverse events potentially related to the medication and its administration.

Source: https://euclinicaltrials.eu/ctis-public/view/2024-516561-37-01